EU clinical trial 2024-512014-17-02: The headache-inducing effects of sildenafil in men and women with episodic migraine without aura.
Sponsor: Syddansk Universitet (University of Southern Denmark) (Educational Institution). Phase: Phase I and Phase II (Integrated)- Other. Countries: Denmark (ended).
Therapeutic area(s): Diseases [C] - Nervous System Diseases [C10]
Gender: Female, Male. Age: 18-64 years. Enrolment: 27.
Status: Ended. Start date (EU): 2024-11-01. End date (EU): 2025-07-10. Decision date: 2024-08-03. Results received: Yes. Last updated: 2024-08-03.

Condition(s): Migraine without aura
Product: Ibuprofen Teva 400 mg, filmomhulde tabletten., GLUCOSE MONOHYDRATE, Sildenafil Orion 100 mg filmdragerade tabletter, Sumatriptan Accord 100 mg, filmomhulde tabletten

Primary endpoint: Difference in the occurrence of migraine-like attacks in sildenafil- and placebo-treated men with migraine without aura., Difference in the occurrence of migraine-like attacks in sildenafil-treated men and women with migraine without aura.
Endpoint(s): Difference in the occurrence of headache in sildenafil- and placebo-treated men with migraine without aura., Difference in heart rate and mean arterial pressure (MAP) between sildenafil- and placebo-treated men with migraine without aura, Difference in the incidence of adverse events between sildenafil- and placebo-treated men with migraine without aura

Source: https://euclinicaltrials.eu/ctis-public/view/2024-512014-17-02